EU clinical trial 2024-517335-46-00: A Phase 2 Open-label Randomized Study of V940 in Combination With BCG Versus BCG Monotherapy in Participants With High-risk Non-muscle Invasive Bladder Cancer (INTerpath-011)
Protocol code: V940-011
Sponsor: Merck Sharp & Dohme LLC (Pharmaceutical company). Phase: Therapeutic exploratory (Phase II). Countries: Italy (ongoing, recruiting), Germany (ongoing, recruiting), Denmark (ongoing, recruiting), Poland (ongoing, recruiting), Spain (ongoing, recruiting), France (ongoing, recruiting), Greece (ongoing, recruiting), Netherlands (ongoing, recruiting), Hungary (ongoing, recruiting).
Therapeutic area(s): Diseases [C] - Neoplasms [C04]
Gender: Female, Male. Age: 18-64 years, 65+ years. Enrolment: 138.
Status: Ongoing, recruiting. Start date (EU): 2025-06-05. Decision date: 2025-04-23. Results received: No. Last updated: 2026-06-29.
Decision dates by country: HU: 2025-04-25, PL: 2025-04-27, FR: 2025-04-28, GR: 2025-04-24, IT: 2025-04-24, ES: 2025-04-23, DE: 2025-04-25, NL: 2025-04-28, DK: 2025-04-23

Condition(s): Bladder cancer
Product: mRNA-4157, BCG VACCINE

Primary endpoint: Cohort A: Event-Free Survival (EFS)
Endpoint(s): Cohort A: 12-month EFS Rate, Cohort A: 24-month EFS Rate, Cohort A: Recurrence-Free Survival (RFS), Cohort A: Disease-Specific Survival (DSS), Cohort A: Overall Survival (OS), Cohort A: 12-month OS Rate, Cohort A: 24-month OS Rate, Cohort A: Complete Response Rate (CRR), Cohort A: Duration of Response (DOR), Cohort A: Time to Cystectomy, Cohort A: Number of Participants who Experience an Adverse Event (AE), Cohort A: Number of Participants Who Discontinue Study Treatment Due to an AE

Source: https://euclinicaltrials.eu/ctis-public/view/2024-517335-46-00